EU clinical trial 2025-523933-24-00: A Randomized, Open-label, Parallel-group Phase III Study to Evaluate the Efficacy, Safety, and Tolerability of Elecoglipron Compared with Oral Semaglutide in Adults with Type 2 Diabetes Mellitus (Eluminate-2)
Protocol code: D7261C00005
Sponsor: AstraZeneca AB (Pharmaceutical company). Phase: Therapeutic confirmatory (Phase III). Countries: Poland (authorised, recruitment pending), Hungary (authorised, recruitment pending), Italy (authorised, recruitment pending), Bulgaria (authorised, recruitment pending), Germany (authorised, recruitment pending).
Therapeutic area(s): Diseases [C] - Nutritional and Metabolic Diseases [C18]
Gender: Female, Male. Age: 18-64 years, 65+ years. Enrolment: 335.
Status: Authorised, recruitment pending. Decision date: 2026-07-22. Results received: No. Last updated: 2026-08-06.
Decision dates by country: BG: 2026-07-31, DE: 2026-07-22, HU: 2026-07-27, IT: 2026-07-31, PL: 2026-07-29

Condition(s): type 2 diabetes mellitus
Product: Elecoglipron, Elecoglipron, Rybelsus 9 mg tablets, Elecoglipron, Rybelsus 4 mg tablets, Elecoglipron, Rybelsus 1.5 mg tablets

Primary endpoint: Change from baseline to Week 52 in HbA1c (%)
Endpoint(s): Percent change from baseline to Week 52 in body weight, Change from baseline to Week 52 in body weight (kg), Achieved ≥ 5% weight loss from baseline at Week 52 and achieved HbA1c < 7% (53 mmol/mol) at Week 52, Achieved HbA1c ≤ 6.5% (48 mmol/mol) at Week 52, Achieved HbA1c < 7% (53 mmol/mol) at Week 52

Source: https://euclinicaltrials.eu/ctis-public/view/2025-523933-24-00